EU clinical trial 2022-501668-16-00: B7981040 - A PHASE 3 RANDOMIZED, DOUBLE-BLIND, 52-WEEK PLACEBOCONTROLLED, MULTI-CENTER STUDY INVESTIGATING THE EFFICACY, SAFETY, AND TOLERABILITY OF RITLECITINIB IN ADULT AND ADOLESCENT PARTICIPANTS WITH NONSEGMENTAL VITILIGO
Protocol code: B7981040
Sponsor: Pfizer Inc. (Pharmaceutical company). Phase: Therapeutic confirmatory (Phase III). Countries: Bulgaria (ended), Spain (ended), Germany (ended), Italy (ended), Poland (ended).
Therapeutic area(s): Diseases [C] - Skin and Connective Tissue Diseases [C17]; Diseases [C] - Immune System Diseases [C20]
Gender: Female, Male. Age: 0-17 years, 18-64 years, 65+ years. Enrolment: 81.
Status: Ended. Start date (EU): 2023-06-26. End date (EU): 2026-02-05. End date: 2026-02-06. Decision date: 2023-04-04. Results received: No. Last updated: 2025-07-21.
Decision dates by country: IT: 2023-04-04, BG: 2023-04-05, DE: 2023-04-04, ES: 2023-04-04, PL: 2023-04-05

Condition(s): NON SEGMENTAL VITILIGO
Product: DEXAMETHASONE, placebo for the PF-06651600 50mg, Ritlecitinib tosilate

Primary endpoint: Response based on F-VASI75 (defined as at least 75% improvement in F-VASI from BL) at Week 52; • Incidence of treatment-emergent adverse events (TEAEs), serious adverse events (SAEs), and adverse events (AEs) leading to discontinuation. • Incidence of clinically significant laboratory abnormalities
Endpoint(s): Response based on F-VASI75 at Weeks 24 and 36, Response based on T-VASI50 at Weeks 24, 36, and 52, % CFB in F-VASI at Weeks 24, 36, and 52., % CFB in T-VASI at Weeks 24, 36, and 52., Response based on improvement in PGIS-Fb at Weeks 24, 36, and 52, Response based on improvement in PGIS-Vc at Weeks 24, 36, and 52

Source: https://euclinicaltrials.eu/ctis-public/view/2022-501668-16-00